EU clinical trial 2023-510135-10-00: Phase II study of dornase alpha and cisplatin in refractory germ cell cancer.
Protocol code: GCTSK-007
Sponsor: Narodny Onkologicky Ustav (Hospital/Clinic/Other health care facility). Phase: Therapeutic exploratory (Phase II). Countries: Slovakia (authorised, recruitment pending).
Therapeutic area(s): Diseases [C] - Neoplasms [C04]
Gender: Male. Age: 18-64 years, 65+ years. Enrolment: 33.
Status: Authorised, recruitment pending. Decision date: 2025-07-09. Results received: No. Last updated: 2025-08-05.
Decision dates by country: SK: 2025-08-05

Condition(s): germ cell cancer
Product: CISPLATIN, Pulmozyme 2 500 U/2,5 ml roztok na rozprašovanie

Primary endpoint: 12-week progression-free survival (intent-to-treat population)
Endpoint(s): Overall response rate (ORR) by RECIST 1.1 and tumor markers (AFP, HCG, LDH), Progression-free survival, Overall survival, Toxicity, Frequency of grade III and IV adverse events, Association between clinical outcome and biomarkers (exploratory analysis)

Source: https://euclinicaltrials.eu/ctis-public/view/2023-510135-10-00